EU clinical trial 2023-508281-15-00: A Phase 1 First-in Human, Multi-Center, Open Label Dose-Escalation Study to Determine the Safety, Tolerability, Pharmacokinetics and RP2D of ABBV-151 as a Single Agent and in Combination with ABBV-181 in Subjects with Locally Advanced or Metastatic Solid Tumors
Protocol code: M19-345
Sponsor: AbbVie Deutschland GmbH & Co. KG (Pharmaceutical company). Phase: Human Pharmacology (Phase I)- First administration to humans. Countries: France (ongoing, recruitment ended), Spain (ongoing, recruitment ended), Belgium (ended), Germany (ongoing, recruitment ended), Italy (ended), Poland (ongoing, recruitment ended).
Therapeutic area(s): Diseases [C] - Neoplasms [C04]
Gender: Female, Male. Age: 18-64 years, 65+ years. Enrolment: 120.
Start date (EU): 2020-11-10. Decision date: 2024-03-05. Results received: No. Last updated: 2026-02-19.
Decision dates by country: DE: 2024-12-02, IT: 2024-12-11, PL: 2024-12-11, BE: 2024-03-08, FR: 2024-03-11, ES: 2024-03-05

Condition(s): Locally Advanced or Metastatic Solid Tumors, Solid Tumors
Product: Livmoniplimab, Budigalimab

Primary endpoint: Dose Escalation Phase: The determination of the RP2D of ABBV-151 as monotherapy and in combination with budigalimab, Dose Expansion Phase: Objective Response Rate of CR or PR
Endpoint(s): Dose Escalation Phase: Assessment of AEs, serious AEs (SAEs), laboratory parameters, vital signs, electrocardiogram (ECG) results, PK measurements, and antidrug antibody (ADA) measurements., Dose Expansion Phase: Duration of response (DOR), Dose Expansion Phase: Progression-free survival (PFS), Dose Expansion Phase: Assessment of AEs, SAEs, laboratory parameters, vital signs, ECG results, PK, and ADA measurements

Source: https://euclinicaltrials.eu/ctis-public/view/2023-508281-15-00